EU clinical trial 2023-503203-29-00: An Open-label Study to Assess the Safety, Tolerability, Pharmacokinetics and Pharmacodynamics of NT-0796 in Healthy Volunteers and Patients with Parkinson’s Disease.
Protocol code: NT-0796-P002
Sponsor: Nodthera Limited (Pharmaceutical company). Phase: Human Pharmacology (Phase I)- Other. Countries: Netherlands (ended).
Therapeutic area(s): Diseases [C] - Nervous System Diseases [C10]
Gender: Female, Male. Age: 18-64 years, 65+ years. Enrolment: 14.
Status: Ended. Start date (EU): 2023-04-12. End date (EU): 2023-12-18. Decision date: 2023-04-12. Results received: Yes. Last updated: 2023-09-11.

Condition(s): Parkinson's Disease
Product: Lidocaïnehydrochloride 10 mg/ml, injectievloeistof, NADROPARIN

Primary endpoint: Incidence of treatment-emergent adverse events (TEAEs), Changes in clinical laboratory values

Source: https://euclinicaltrials.eu/ctis-public/view/2023-503203-29-00